EU clinical trial 2023-509651-14-00: A3921145 - A LONG-TERM, OPEN-LABEL FOLLOW-UP STUDY OF TOFACITINIB FOR TREATMENT OF JUVENILE IDIOPATHIC ARTHRITIS (JIA)
Protocol code: A3921145
Sponsor: Pfizer Inc. (Pharmaceutical company). Phase: Phase II and Phase III (Integrated). Countries: Spain (ended), Belgium (ended), Poland (ended).
Therapeutic area(s): Diseases [C] - Immune System Diseases [C20]
Gender: Female, Male. Age: 0-17 years. Enrolment: 8.
Status: Ended. Start date (EU): 2013-04-03. End date (EU): 2024-12-18. End date: 2025-02-12. Decision date: 2024-06-17. Results received: Yes. Last updated: 2025-01-21.
Decision dates by country: BE: 2024-06-18, ES: 2024-06-17, PL: 2024-07-10

Condition(s): Juvenile Idiopathic Arthritis (JIA)
Product: TOFACITINIB, TOFACITINIB, Tofacitinib citrate

Primary endpoint: Standard laboratory safety data and adverse event (AE) reports. Body weight, height and Tanner Stages will be collected to assess growth and physical development.
Endpoint(s): Physician global evaluation of disease activity at each visit., Number of joints with active arthritis at each visit., Number of joints with limitation of motion at each visit., Index of inflammation (C reactive protein [CRP]) and Erythrocyte Sedimentation Rate [ESR]) at each visit., Childhood Health Assessment Questionnaire (CHAQ) at each visit., Parent's Assessment of Physical Function (CHAQ Disability Index)., Parent's Assessment of Child's Arthritis Pain (CHAQ Discomfort Index, Visual Analog Scale [VAS])., Parent's Assessment of Overall Wellbeing (CHAQ subsection Visual Analog Scale [VAS])., JIA American College of Rheumatology (ACR) response and occurrence of JIA ACR disease flare at each visit., JIA American Clinical Inactive Disease status and Clinical Remission of Medication at each visit and occurrence of JIA ACR disease flare at each visit after Month 3., Change from baseline in Juvenile Arthritis Disease Activity Score (JADAS) 27-CRP and JADAS 27-ESR, and occurrence of JADAS minimum disease activity and inactive disease at each visit., Eligibility of tapering defined per protocol for corticosteroids, MTX/lefluomide, and tofacitinib., In subjects with sJIA: "Absence of Fever", defined as absence of fever due to sJIA in the week preceding the assessment at each visit., In subjects with Enthesitis Related Arthritis (ERA): Change from baseline in the Tender Entheseal Assessment, Modified Schober's Test, Overall Back Pain and Nocturnal Back Pain response at various visits., In subjects with psoriatic arthritis (PsA): Change from baseline in body surface area (BSA) affected by psoriasis and Physician's Global Assessment (PGA) of psoriasis) at various visits.

Source: https://euclinicaltrials.eu/ctis-public/view/2023-509651-14-00